EU clinical trial 2023-507695-52-00: A Phase 3 Open-Label, Randomized Study of LOXO-305 versus Investigator Choice of BTK Inhibitor in Patients with Previously Treated BTK Inhibitor Naïve Mantle Cell Lymphoma (BRUIN-MCL-321)
Protocol code: LOXO-BTK-20019
Sponsor: Loxo Oncology Inc. (Pharmaceutical company). Phase: Therapeutic confirmatory (Phase III). Countries: Portugal (ongoing, recruitment ended), Belgium (ongoing, recruitment ended), Czechia (ongoing, recruitment ended), Austria (ongoing, recruitment ended), Denmark (ongoing, recruitment ended), Spain (ongoing, recruitment ended), France (ongoing, recruitment ended), Germany (ongoing, recruitment ended), Netherlands (ongoing, recruitment ended), Poland (ongoing, recruitment ended), Italy (ongoing, recruitment ended).
Therapeutic area(s): Diseases [C] - Neoplasms [C04]
Gender: Female, Male. Age: 18-64 years, 65+ years. Enrolment: 197.
Status: Ongoing, recruitment ended. Start date (EU): 2021-03-05. Decision date: 2024-06-12. Results received: No. Last updated: 2026-07-20.
Decision dates by country: PT: 2024-06-12, CZ: 2024-06-13, DE: 2024-06-13, DK: 2024-06-12, PL: 2024-06-13, FR: 2024-06-12, NL: 2024-06-12, IT: 2024-06-17, AT: 2024-06-17, ES: 2024-06-13, BE: 2024-06-13

Condition(s): Mantle cell lymphoma
Product: PIRTOBRUTINIB, IBRUTINIB, IBRUTINIB, PIRTOBRUTINIB

Primary endpoint: Assessed by independent review committee (IRC) • Progression-free survival (PFS) per Lugano criteria

Source: https://euclinicaltrials.eu/ctis-public/view/2023-507695-52-00